EU clinical trial 2025-522398-12-00: A study of gilteritinib in adults with advanced ALK-positive non-small cell lung cancer (NSCLC)
Protocol code: 2215-CL-5201
Sponsor: Astellas Pharma Global Development Inc. (Pharmaceutical company). Phase: Human Pharmacology (Phase I)- Other. Countries: France (ongoing, recruiting), Spain (ongoing, recruiting).
Therapeutic area(s): Diseases [C] - Neoplasms [C04]
Gender: Female, Male. Age: 18-64 years, 65+ years. Enrolment: 12.
Status: Ongoing, recruiting. Start date (EU): 2026-01-30. Decision date: 2026-01-14. Results received: No. Last updated: 2026-07-17.
Decision dates by country: FR: 2026-01-14, ES: 2026-01-19

Condition(s): Locally advanced or metastatic NSCLC

Source: https://euclinicaltrials.eu/ctis-public/view/2025-522398-12-00